EU clinical trial 2024-513289-21-00: Prospective, randomized, non-treatment controlled, investigator-blinded, multicenter study on the prophylaxis of early childhood symptoms of atopic dermatitis in high-risk children by continuous continuous application of a moisturizing barrier-stabilizing skin cream
Protocol code: MOPAD
Sponsor: INFECTOPHARM Arzneimittel und Consilium GmbH (Pharmaceutical company). Phase: Therapeutic confirmatory (Phase III). Countries: Germany (ongoing, recruitment ended).
Therapeutic area(s): Diseases [C] - Skin and Connective Tissue Diseases [C17]
Gender: Female, Male. Age: 0-17 years. Enrolment: 360.
Status: Ongoing, recruitment ended. Start date (EU): 2020-01-13. Decision date: 2024-10-17. Results received: No. Last updated: 2026-03-17.

Condition(s): Children with a high risk of developing atopic dermatitis
Product: SanaCutan® Basiscreme

Primary endpoint: The primary end point is defined as the cumulative incidence of atopic dermatitis (AD) at the age of 6 months. AD is confirmed if in at least 2 examinations at an interval of at least 4 weeks (initial diagnosis + evidence of chronification) an AD is diagnosed. A confirmed AD is abbreviated as "AD" in the context of the study (this does not refer to the initial detection of AD symptoms).
Endpoint(s): Cumulative incidence of children with AD at 12 and 16 weeks, 9, 12 and 6-12 months, Cumulative incidence of children with preliminary diagnosis of atopic dermatitis (regardless of whether chronification is confirmed at 12 and 16 weeks, 6, 9 and 12 months of age, Time to onset of AD at 0-6, 6-12 and 0-12 months of age, Cumulative incidence and frequency of children with xerosis at 6 and 12 months of age, Cumulative incidence and frequency of children with signs of itching at 6 and 12 months of age, Cumulative incidence and frequency of children with eczema of other types at 6 and 12 months of age, Severity of AD at the time of detection of (confirmed) AD up to 12 and 16 weeks and 6, 9 and 12 months of age, Frequency of sensitization to food allergens (according to Fx5 test + hazelnut) and to inhalation allergens (according to Sx1 test) and total IgE at the age of 6, 9 and 12 months, Adverse events: overall frequency, type, severity, causality, with frequencies, separate presentation of local reactions up to 6 and 12 months of age, Drop-outs (with reasons) up to 6 and 12 months of age, Compliance regarding the use of the investigational medicinal product in the treatment group up to the age of 6, 12 and 6-12 months, Compliance regarding the use of other skin care products (not investigational medicinal product) in both groups up to the age of 6, 12 and 6-12 months

Source: https://euclinicaltrials.eu/ctis-public/view/2024-513289-21-00